EU clinical trial 2024-519145-30-00: A Phase 1, Double-blind, Randomized, Two-arm, Parallel Group Study to Compare the Pharmacokinetics and Safety of a Single Subcutaneous Dose of PBP1502 and EU-Humira® in Healthy Male and Female Subjects
Protocol code: SOLOMON-I
Sponsor: Prestige Biopharma Ltd (Pharmaceutical company). Phase: Human Pharmacology (Phase I)- Other. Countries: Spain (ongoing, recruitment ended).
Therapeutic area(s): Not possible to specify
Gender: Female, Male. Age: 18-64 years. Enrolment: 112.
Status: Ongoing, recruitment ended. Start date (EU): 2026-07-29. Decision date: 2024-10-31. Results received: No. Last updated: 2026-06-12.

Condition(s): Healthy volunteers

Source: https://euclinicaltrials.eu/ctis-public/view/2024-519145-30-00